EU clinical trial 2023-507890-17-00: A Phase 3, Double-Blind, Randomized Study to Compare the Efficacy and Safety of Luspatercept (ACE-536) Versus Placebo in Subjects with Myeloproliferative Neoplasm-Associated Myelofibrosis on Concomitant JAK2 Inhibitor Therapy and Who Require Red Blood Cell Transfusions
Protocol code: ACE-536-MF-002
Sponsor: Celgene Corp. (Pharmaceutical company). Phase: Therapeutic confirmatory (Phase III). Countries: Germany (ongoing, recruitment ended), Czechia (ongoing, recruitment ended), Romania (ongoing, recruitment ended), Ireland (ended), Austria (ended), Greece (ongoing, recruitment ended), France (ongoing, recruitment ended), Spain (ongoing, recruitment ended), Poland (ongoing, recruitment ended), Hungary (ended), Belgium (ongoing, recruitment ended), Italy (ongoing, recruitment ended).
Therapeutic area(s): Diseases [C] - Hemic and Lymphatic Diseases [C15]
Gender: Female, Male. Age: 18-64 years, 65+ years. Enrolment: 150.
Start date (EU): 2021-02-22. Decision date: 2024-03-04. Results received: No. Last updated: 2026-01-05.
Decision dates by country: HU: 2024-03-06, IE: 2024-03-04, BE: 2024-03-05, DE: 2024-03-06, AT: 2024-03-25, CZ: 2024-03-07, GR: 2024-03-22, FR: 2024-03-05, ES: 2024-03-06, IT: 2024-05-29, RO: 2024-03-06, PL: 2024-04-02

Condition(s): Anemia associated with myeloproliferative neoplasm (MPN)-associated myelofibrosis (MF)
Product: 0.9 % w/v Sodium Chloride Injection, Reblozyl 25 mg powder for solution for injection, Reblozyl 75 mg powder for solution for injection

Primary endpoint: The Primary end point of RBC-transfusion is defined as the proportion of subjects who become RBC transfusion free during any consecutive 12-week period
Endpoint(s): The key secondary endpoint, defined as the proportion of subjects who become RBC-transfusion free over any consecutive 16-week period starting during the Blinded Core Treatment Period (the time from randomization up to and including Week 24) and referred to as RBC-TI 16..., .....will be tested in the same manner as the primary efficacy endpoint once superiority ofluspatercept on the primary endpoint is demonstrated.

Source: https://euclinicaltrials.eu/ctis-public/view/2023-507890-17-00